EU clinical trial 2022-501902-36-00: Efficacy of intravesical oxybutynin in children with neurogenic bladder dysfunction: A randomized, prospective controlled multi-center trial.
Protocol code: 2019PI119
Sponsor: Centre Hospitalier Regional Universitaire De Nancy (Hospital/Clinic/Other health care facility). Phase: Therapeutic confirmatory (Phase III). Countries: France (ongoing, recruiting).
Therapeutic area(s): Diseases [C] - Congenital, Hereditary, and Neonatal Diseases and Abnormalities [C16]
Gender: Female, Male. Age: 0-17 years. Enrolment: 60.
Status: Ongoing, recruiting. Start date (EU): 2026-01-15. Decision date: 2025-01-09. Results received: No. Last updated: 2026-03-19.

Condition(s): spina bifida
Product: VESOXX 1 mg/ml, Lösung zur intravesikalen Anwendung, Sterile 0.9% NaCl solution for intravesical instillation.

Primary endpoint: Evolution of maximal bladder capacity at 4 weeks of treatment (end of follow-up).
Endpoint(s): Evolution of maximal bladder pressure at 4 weeks of treatment (end of follow-up)., Time to clinical treatment failure defined by criteria found in literature and marketing authorization of Botox® in a 28-day time frame (at least one of the 3 criteria): Treatment judged as non-effective by either the patient or the practitioner; Reduction of urinary incontinence to less than 50% of the initial occurrences measured in the initial bladder diary; Intolerable side effects reported by the patient., Evaluation of tolerance and side effects: digestive, psychiatric, neurological, cutaneous, urological, pain associated with instillation., Proportion of responders at 4 weeks of treatment (patients who had at least a 50% reduction in urinary incontinence episodes)., Proportion of continent patients at 4 weeks of treatment (patients who had a 100% reduction in urinary incontinence episodes)., Product usability measured with usability questionnaire (UMUX-LITE and specific questions)., Standardized difference in patient quality of life calculated according to the ICIQ-UI-SF and KIDSCREEN-10 score between the beginning and the end of the study., Evolution of the elements of the bladder diary at 4 weeks of treatment: Number and volume of urinary catheterizations over 72 hours during the week preceding each visit (V1, V2 and V3)., Evolution of the elements of the other urodynamic assessments at 4 weeks of treatment: Bladder compliance; Minimum filling volume causing uninhibited detrusor contraction., Evolution of renal ultrasonography at 4 weeks of treatment: Renal pelvis anteroposterior diameter; Ureters diameter.

Source: https://euclinicaltrials.eu/ctis-public/view/2022-501902-36-00